EU clinical trial 2025-521490-13-00: ImmunotherApy for the Prevention of High-Risk Oral DIsorders malignanT transformation - APHRODITE trial
Protocol code: APHRODITE
Sponsor: Humanitas Mirasole S.p.A. (Hospital/Clinic/Other health care facility). Phase: Therapeutic exploratory (Phase II). Countries: Italy (authorised, recruiting).
Therapeutic area(s): Diseases [C] - Otorhinolaryngologic Diseases [C09]; Diseases [C] - Neoplasms [C04]
Gender: Female, Male. Age: 18-64 years, 65+ years. Enrolment: 31.
Status: Authorised, recruiting. Start date (EU): 2025-07-30. Decision date: 2025-07-08. Results received: No. Last updated: 2026-05-06.

Condition(s): Oral disorders

Primary endpoint: Best overall response rate (CR + PR rate) at 6 months, as defined by the percent change in clinical-pathologic composite score
Endpoint(s): • Evaluate 3 years and overall malignant transformation rate • Measure drug-induced adverse events and any treatment interruption due to toxicities • Evaluate the change of histological grading of OPMD (based on the World Health Organization WHO classification), • Assess patient reported outcomes, measured via PRO CTCAE at treatment start, at 6 months and then every three months for the following 18 months. Questionnaire will be derived by the NCI- PRO-CTCAE ITEMS-ITALIAN • To assess impact on patients’ quality of life, measured via EORTC QLQC30-HN43, Exploratory Endpoints • Correlate selected biomarkers in tissue and saliva with malignancy-free survival. • Assess narrow-band imaging (NBI) changes during the study treatment and follow up, • To evaluate the LOH status (to be considered positive in patients carrying OPMD with LOH at 3p14 and/or 9p21 plus at least at one additional chromosomal site (4q, 8p,11p,13q, or 17p) or in patients carrying OPMD with a prior oral cancer history and LOH at 3p14 and/or 9p21 (LOH defined according to EPOC trial) at baseline, at 6 months, and in case of malignant transformation.

Source: https://euclinicaltrials.eu/ctis-public/view/2025-521490-13-00